EU clinical trial 2024-516873-57-00: Phase 3 trial aimed at improving the overall survival of AML in adults aged 18 to 60 by comparing high-dose idarubicin with daunorubicin at induction, high-dose and intermediate-dose cytarabine at consolidation and mycophenolic acid as standard prophylaxis in the prevention of graft versus host disease in allograft patients in first complete remission after reduced conditioning: Backbone Inter-Group-1 (BIG-1) trial
Protocol code: BIG-1
Sponsor: Centre Hospitalier Universitaire D'Angers (Hospital/Clinic/Other health care facility). Phase: Phase II and Phase III (Integrated). Countries: France (ongoing, recruitment ended).
Therapeutic area(s): Diseases [C] - Hemic and Lymphatic Diseases [C15]
Gender: Female, Male. Age: 18-64 years. Enrolment: 3100.
Status: Ongoing, recruitment ended. Start date (EU): 2026-01-13. Decision date: 2024-10-24. Results received: No. Last updated: 2026-02-03.

Condition(s): Acute myeloid leukemia in adults aged 18 to 60
Product: CYTARABINE, Venetoclax

Primary endpoint: For R1 and R2 randomizations: The primary endpoint will be a comparison of overall survival (OS) at 3 years according to the treatment considered (idarubicin vs. daunorubicin for randomization 1, and high-dose cytarabine 3.0 g/m2 vs. intermediate-dose cytarabine 1.5 g/m2 for randomization 2). For R3 randomization: The primary endpoint will be the cumulative incidence of grade II to IV acute GvHD at D100, compared according to the GvHD prophylaxis regimen considered (standard regimen or mycopheno

Source: https://euclinicaltrials.eu/ctis-public/view/2024-516873-57-00